EU clinical trial 2024-516054-21-00: A Prospective Phase III Multi-center, 2-Year Placebo Controlled, Double Blind Study to Evaluate the Efficacy and Safety of “Kamada-AAT for Inhalation” 80 mg per Day in Adult Patients with Congenital Alpha-1 Antitrypsin Deficiency with Moderate and Severe Airflow Limitation (40% ≤ FEV1 ≤ 80% of predicted; FEV1/SVC ≤ 70%), Followed by a 2-Year Open- Label Extension
Protocol code: KamadaAATInhaled008
Sponsor: Kamada Ltd. (Pharmaceutical company). Phase: Therapeutic confirmatory (Phase III). Countries: Finland (ended), Ireland (ended), Sweden (ended), Belgium (ended), Netherlands (ended).
Therapeutic area(s): Diseases [C] - Respiratory Tract Diseases [C08]
Gender: Female, Male. Age: 18-64 years, 65+ years. Enrolment: 108.
Status: Ended. Start date (EU): 2019-10-25. End date (EU): 2026-02-27. End date: 2026-02-28. Decision date: 2024-09-23. Results received: No. Last updated: 2025-12-10.
Decision dates by country: BE: 2024-09-25, IE: 2024-09-24, SE: 2024-09-24, FI: 2024-09-27, NL: 2024-09-23

Condition(s): Adult Patients with Congenital Alpha-1 Antitrypsin Deficiency with Moderate and Severe Airflow Limitation (40% ≤ FEV1 ≤ 80% of predicted; FEV1/SVC ≤ 70%), and with no history of two or more moderate or one or more severe exacerbations of COPD during the past year.
Product: Kamada-AAT for Inhalation, Placebo for “Kamada-AAT for Inhalation”

Primary endpoint: FEV1 (L) post bronchodilator change from baseline at 104 weeks.
Endpoint(s): Change from baseline over 104 weeks of treatment in CT densitometry whole-lung 15th percentile lung density (PD15) at total lung capacity (TLC)., Change from baseline over 104 weeks of treatment in Post bronchodilator spirometry measures a. FEV1 % of predicted b. FEV1/FVC %, Exacerbations over 104 weeks of treatment; annual rate by severity and duration., Change from Baseline over 104 weeks of treatment in 6 minute walk test (6MWT).

Source: https://euclinicaltrials.eu/ctis-public/view/2024-516054-21-00